EU clinical trial 2024-516282-37-00: Preservation of Fertility by Ovarian Stimulation Associated With Tamoxifen, Prior Chemotherapy for Breast Cancer (PRESAGE)
Protocol code: ICO-N-2013-03
Sponsor: Institut De Cancerologie De L Ouest (Hospital/Clinic/Other health care facility). Phase: Therapeutic exploratory (Phase II). Countries: France (ongoing, recruiting).
Therapeutic area(s): Diseases [C] - Neoplasms [C04]
Gender: Female. Age: 18-64 years. Enrolment: 100.
Status: Ongoing, recruiting. Start date (EU): 2025-02-18. Decision date: 2024-08-09. Results received: No. Last updated: 2024-08-09.

Condition(s): Breast cancer
Product: Puregon 300 IU/0.36 mL solution for injection, Cetrotide 0.25 mg powder and solvent for solution for injection, NOLVADEX 10 mg, comprimé pelliculé, Ovitrelle 250 micrograms solution for injection in pre-filled pen

Primary endpoint: The feasibility of ovarian stimulation combining Tamoxifen with recombinant FSH as part of fertility preservation prior to chemotherapy for breast cancer will be assessed on the basis of the number of oocytes and/or embryos obtained per patient included.
Endpoint(s): Evaluation of the average time taken to start chemotherapy: time (in days) between the day of the consultation with the oncologist and the day of administration of the first chemotherapy treatment, Overall survival / event-free survival at 10 years., Number of pregnancies obtained: number of positive beta HCG and number of clinical pregnancies., Ancillary study (Nantes patients only): Analysis of plasma concentrations of tamoxifen and its metabolites, 4 -hydroxytamoxifen, N - desmethyltamoxifen and endoxifen

Source: https://euclinicaltrials.eu/ctis-public/view/2024-516282-37-00